EU clinical trial 2023-505048-20-00: BLOCKADE OF THE RENIN-ANGIOTENSIN-ALDOSTERONE SYSTEM IN PATIENTS WITH ARVD: A DOUBLE-BLIND MULTICENTRE PROSPECTIVE RANDOMIZED STUDY BRAVE
Protocol code: 69HCL18_0038
Sponsor: Hospices Civils De Lyon (Hospital/Clinic/Other health care facility). Phase: Therapeutic exploratory (Phase II). Countries: France (temporarily halted).
Therapeutic area(s): Diseases [C] - Cardiovascular Diseases [C14]
Gender: Female, Male. Age: 18-64 years, 65+ years. Enrolment: 120.
Status: Temporarily halted. Start date (EU): 2024-12-20. Decision date: 2023-08-24. Results received: No. Last updated: 2026-02-06.

Condition(s): Arrhythmogenic right ventricular dysplasia
Product: Spironolactone 25mg Tablets, Lactose / 1% Magnesium Stearate blend.

Primary endpoint: Right ventricular deterioration is defined by a decrease in RV longitudinal strain or/and increase of RV infundibulum diameter between baseline and 1 year of follow-up measured by echography. Ventricular arrhythmia is defined by the change in arrhythmia, defined as a number of occurrences of ventricular extrasystoles > 500 during a 24h-Holter ECG monitor test, between baseline and 1 year of follow-up
Endpoint(s): Ventricular arrhythmia is defined by number of ventricular extrasystoles during a 24h-Holter ECG monitor test, between baseline and 1 year of follow-up., Functional status is defined by presence/absence and number of palpitations, ventricular tachycardia, dyspnea, syncope, sudden death, thoracic pain, MACE, and hospital admissions owing to clinical deterioration during the 1 year of follow-up, LV function (LV diameters, LV volumes, LVEF, LVGLS, presence of aneurism, % of dyskinesia), size of RV (LVOT diameters - PLAX and SAX, end-diastolique area, end-systolique area, 3D volumes), RV function (fractional shortening, presence of aneurism , % dyskinesia, TAPSE, tissue Doppler velocity, 3D RVEF, lateral longitudinal strain, global longitudinal strain) on echography between baseline and 1 year , and evolution of QRS width and PR duration on ECG between baseline and 1 year, RV function (fractional shortening, presence of aneurism , % dyskinesia, TAPSE, tissue Doppler velocity, 3D RVEF, lateral longitudinal strain, global longitudinal strain) using echocardiography and arrhythmia burden using 24h Holter-ECG at 1 year of follow-up according to the genotype (No mutation versus, at least, one mutation on desmosome genes)., Quantification of fibrosis and inflammation (measured at baseline and 1-year of follow-up) by dosage of MMP9, TIMP1, TIMP2, IL6 and IL8, Ventricular arrhythmia is defined by number of ventricular extrasystoles during a 24h-Holter ECG monitor test, between baseline and 3 years of follow-up, Functional status is defined by presence/absence and number of palpitations, ventricular tachycardia, dyspnea, syncope, sudden death, thoracic pain, MACE, and hospital admissions owing to clinical deterioration during the 3 years of follow-up., Left Ventricle (LV) function (LV diameters, LV volumes, LVEF, LVGLS, presence of aneurism, % of dyskinesia), size of RV (LVOT diameters - PLAX and SAX, end-diastolique area, end-systolique area, 3D volumes), RV function (fractional shortening, presence of aneurism , % dyskinesia, TAPSE, tissue Doppler velocity, 3D RVEF, lateral longitudinal strain, global longitudinal strain) on echography between baseline and 3 years, and evolution of QRS width and PR duration on ECG between baseline and 3 year, RV function (fractional shortening, presence of aneurism , % dyskinesia, TAPSE, tissue Doppler velocity, 3D RVEF, lateral longitudinal strain, global longitudinal strain) using echocardiography and arrhythmia burden using 24h Holter-ECG at 3 years of follow-up according to the genotype (No mutation versus, at least, one mutation on desmosome genes)., Quantification of fibrosis and inflammation (measured at baseline and 3 years of follow-up) by dosage of MMP9, TIMP1, TIMP2, IL6 and IL8.

Source: https://euclinicaltrials.eu/ctis-public/view/2023-505048-20-00